EU clinical trial 2025-522381-68-00: Intrathecal drug delivery systems versus comprehensive medical management for severe cancer pain: a randomized controlled trial
Sponsor: Vrije Universiteit Brussel (Educational Institution). Phase: Therapeutic use (Phase IV). Countries: Belgium (ongoing, recruiting).
Therapeutic area(s): Analytical, Diagnostic and Therapeutic Techniques and Equipment [E] - Anesthesia and Analgesia [E03]
Gender: Female, Male. Age: 18-64 years, 65+ years. Enrolment: 72.
Status: Ongoing, recruiting. Start date (EU): 2026-06-26. Decision date: 2026-03-04. Results received: No. Last updated: 2026-04-23.

Condition(s): Severe refractory cancer pain
Product: MORPHINE HCl STEROP 10mg/1ml Oplossing voor injectie, MARCAINE 0,5%, oplossing voor injectie, Ropivacaïne Fresenius Kabi 5 mg/ml oplossing voor injectie, MORPHINE HCl STEROP 40mg/1ml Oplossing voor injectie

Primary endpoint: HRQoL will be evaluated with the EORTC QLQ-C30 questionnaire.
Endpoint(s): Patient comfort is evaluated with the General Comfort Questionnaire (GCQ), a self-reported instrument consisting of 48 items that reflect the physical, spiritual, environmental, and social dimension., The survival rate in both groups, CMM and IDD, will be determined by recording the time from treatment initiation until death., Pain intensity will be measured with the VAS (ranging from 0 (no pain) to 100 (maximal pain)) in electronic format., Perceived stress will be assessed by using the 10-item Perceived Stress Scale (PSS; Cohen, Kamarch, & Mermelstein, 1983)., Patient anxiety will be provided through the State Trait Anxiety Inventory (STAI)., Using the Injustice Experience Questionnaire (IEQ), perceived injustice related to current health status will be assessed., The General Self-Efficacy (GSE) Scale is a 10-item self-report questionnaire used to assess perceived self-efficacy., To evaluate caregiver burden, the Zarit Burden Interview (ZBI) questionnaire will be completed., Expenditures related to in-hospital care will be extracted from hospital claims data. All other healthcare-related costs will be gathered through telephone interviews with patients, conducted each month after treatment initiation. During these calls, researchers will ask patients whether they have had any medical consultations, hospital admissions, AEs, changes in medication (daily morphine or MED), or incurred any additional healthcare costs., Safety, all (S)AEs will be documented throughout the duration of the study.

Source: https://euclinicaltrials.eu/ctis-public/view/2025-522381-68-00